EU clinical trial 2024-515436-76-00: The pivotal bioequivalence study comparing the test product to the reference product, which belongs to the group of medicines used in treatment and prevention of Influenza.
Protocol code: CPA 560-24
Sponsor: Adamed Pharma S.A. (Pharmaceutical company). Phase: Human Pharmacology (Phase I)- Bioequivalence Study. Countries: Czechia (ended).
Therapeutic area(s): Diseases [C] - Virus Diseases [C02]
Gender: Female, Male. Age: 18-64 years. Enrolment: 54.
Status: Ended. Start date (EU): 2024-11-13. End date (EU): 2025-05-20. Decision date: 2024-10-23. Results received: No. Last updated: 2025-04-02.

Condition(s): influenza

Source: https://euclinicaltrials.eu/ctis-public/view/2024-515436-76-00